EU clinical trial 2022-502273-42-00: A phase III multicenter, double-blind, randomized, placebo-controlled, parallel-group trial of the efficacy of citicoline eyedrops 2% on visual field preservation in patients with open angle glaucoma
Protocol code: OMK1P3
Sponsor: Omikron Italia S.r.l. (Pharmaceutical company). Phase: Therapeutic confirmatory (Phase III). Countries: Hungary (ended), Belgium (ongoing, recruiting), France (ongoing, recruiting), Spain (ongoing, recruiting), Greece (ongoing, recruiting), Italy (ongoing, recruiting), Poland (ended).
Therapeutic area(s): Diseases [C] - Eye Diseases [C11]
Gender: Female, Male. Age: 18-64 years, 65+ years. Enrolment: 950.
Start date (EU): 2023-11-08. Decision date: 2023-07-20. Results received: No. Last updated: 2026-08-07.
Decision dates by country: HU: 2023-07-31, PL: 2023-07-31, FR: 2023-07-21, GR: 2023-07-25, IT: 2023-07-25, BE: 2023-07-24, ES: 2023-07-20

Condition(s): Glaucoma
Product: Placebo eye drops: vehicle, Hyaluronic acid: 0.02 g; Benzalkonium chloride: 0.001g; water for injection up to 10 ml, Citicoline

Primary endpoint: rate of change in MD in the study eye, an index of the global deviation of the age-corrected normal values. The objective is to assess the difference in the rate of progression over 3 years of study in the experimental arm compared to the control arm
Endpoint(s): To establish differences in the rate of change of structural thickness (peripapillary Retinal Nerve Fibre Layer (RNFL) with Optical Coherence Tomography – OCT) and macular thickness of the inner retina (RNFL, Ganglion Cell Layer and Ganglion Cell + Inner Plexiform Layer complex evaluated by SD-OCT)

Source: https://euclinicaltrials.eu/ctis-public/view/2022-502273-42-00